EU clinical trial 2022-500237-92-00: A phase 3, multicenter, randomized, double-blind, placebo-controlled trial comparing the efficacy and safety of tafasitamab plus lenalidomide in addition to R-CHOP versus R CHOP in previously untreated, high-intermediate and high-risk patients with newly-diagnosed diffuse large B-cell lymphoma (DLBCL) [frontMIND]
Protocol code: MOR208C310
Sponsor: Incyte Corp. (Pharmaceutical company). Phase: Therapeutic confirmatory (Phase III). Countries: Spain (ongoing, recruitment ended), Slovakia (ongoing, recruitment ended), Italy (ongoing, recruitment ended), Czechia (ongoing, recruitment ended), Austria (ongoing, recruitment ended), Hungary (ongoing, recruitment ended), France (ongoing, recruitment ended), Germany (ongoing, recruitment ended), Romania (ongoing, recruitment ended), Ireland (ongoing, recruitment ended), Poland (ongoing, recruitment ended).
Therapeutic area(s): Diseases [C] - Neoplasms [C04]
Gender: Female, Male. Age: 18-64 years, 65+ years. Enrolment: 392.
Status: Ongoing, recruitment ended. Start date (EU): 2021-04-23. Decision date: 2024-04-19. Results received: No. Last updated: 2026-08-05.
Decision dates by country: FR: 2024-04-22, IE: 2024-04-19, AT: 2024-04-24, RO: 2024-04-23, HU: 2024-04-22, PL: 2024-04-24, SK: 2024-04-19, IT: 2024-04-22, CZ: 2024-04-22, ES: 2024-04-19, DE: 2024-04-30

Condition(s): Newly-diagnosed high-intermediate and high-risk diffuse large B-cell lymphoma (DLBCL)
Product: MINJUVI 200 mg powder for concentrate for solution for infusion, Placebo for lenalidomide 15mg, Placebo for lenalidomide 10mg, Placebo for lenalidomide 25mg, VINCRISTINE, LENALIDOMIDE, CYCLOPHOSPHAMIDE, LENALIDOMIDE, DOXORUBICIN, PREDNISONE, LENALIDOMIDE, PREDNISOLONE, RITUXIMAB, SODIUM CHLORIDE

Primary endpoint: Progression-free survival (PFS) is defined as time from date of randomization until Progressive Disease or death from any cause. In this trial the primary endpoint is PFS as assessed by the investigator. Disease progression will be determined based on the Lugano Response Criteria for Malignant Lymphoma (Cheson et al., 2014; Appendix F).
Endpoint(s): Event-free survival (EFS) as assessed by the investigator, Overall survival (OS), Metabolic, positron emission tomography (PET)-negative complete response (CR) rate at end of treatment (EOT) as assessed by the BIRC, Metabolic, PET-negative CR rate at EOT as assessed by the investigator, ORR at EOT as assessed by the investigator, Time to next anti-lymphoma treatment (TTNT), Duration of CR as assessed by the investigator, EFS rate at three (3) years as assessed by the investigator, PFS rate at three (3) years as assessed by the investigator, OS rate at three (3) years, Incidence and severity of treatment emergent adverse events (TEAEs) from the first dose of study medication until the 90th day (inclusive) after last dose of study medication., PFS as assessed by the investigator by COO subtype, Investigator-assessed EFS by COO subtype, OS by COO subtype, Metabolic, PET-negative CR rate at EOT as assessed by the BIRC by COO subtype, Metabolic, PET-negative CR rate at EOT as assessed by the investigator by COO subtype, PFS as assessed by the investigator by locally determined histological subtype, Investigator assessed EFS by locally determined histological subtype, OS by locally determined histological subtype, Metabolic, PET-negative CR rate at EOT as assessed by the BIRC by locally determined histological subtype, Metabolic, PET-negative CR rate at EOT as assessed by the investigator by locally determined histological subtype, Two (2)-year rate of relapse with CNS involvement, as assessed by the investigator, Health-related quality of life (HRQoL), using the European Organisation for the Research and Treatment of Cancer (EORTC) QLQ-C30 and Functional Assessment of Cancer Therapy for Patients with Lymphoma (FACT-Lym) standardized instruments, Serum concentration of tafasitamab at specific time points (trough and maximum plasma concentration (Cmax) levels), Incidence of anti-tafasitamab antibody formation, titer determination of confirmed positive samples

Source: https://euclinicaltrials.eu/ctis-public/view/2022-500237-92-00